EU clinical trial 2024-512911-34-00: Efficacy of psilocybin and trazodone combination in treatment-resistant depression: a randomized controlled proof-of-concept study (PSILOTRAZ)
Protocol code: D24-P003
Sponsor: Groupe Hospitalier Universitaire Paris Psychiatrie & Neuroscience (Hospital/Clinic/Other health care facility). Phase: Therapeutic exploratory (Phase II). Countries: France (ongoing, recruiting).
Therapeutic area(s): Psychiatry and Psychology [F] - Mental Disorders [F03]
Gender: Female, Male. Age: 18-64 years, 65+ years. Enrolment: 112.
Status: Ongoing, recruiting. Start date (EU): 2026-06-30. Decision date: 2025-06-13. Results received: No. Last updated: 2026-05-18.

Condition(s): Treatment-resistant depression
Product: Psilocybin 25 mg Capsules, TRITTICO 60 mg/ml gocce orali, soluzione, PCB2 (Placebo of psilocybin 25mg), Trazodone placebo (pharmaceutical master preparation prepared according to the Good Pharmacy Practice)

Primary endpoint: The efficacy of the single administration of the psilocybin + trazodone 30 mg combination at 1 month will be assessed by the mean difference of Montgomery-Åsberg Depression Rating Scale (MADRS) scores between M1 (V6) and Baseline (V2), between the following groups: psilocybin + trazodone 30 mg (Group 3) and placebo + trazodone (Group 4).
Endpoint(s): MADRS scores at Baseline (V2) and M1 (V6) in the groups not tested in the primary endpoint (Group 1, 2 and 4), MADRS scores at Inclusion (V1), Baseline (V2), H7 (V3), D1 (V4), D7 (V5), M2 (V7) and M3 (V8) in each group (Group 1, 2, 3 and 4), Beck Depression Inventory (BDI) questionnaire scores at Inclusion (V1), Baseline (V2), H7 (V3), D1 (V4), D7 (V5), M1 (V6), M2 (V7) and M3 (V8) in each group, C-SSRS scores at Inclusion (V1), Baseline (V2), H7 (V3), D1 (V4), D7 (V5), M1 (V6), M2 (V7) and M3 (V8) in each group, The response rate, defined as the proportion of patients with 50% reduction in MADRS score in each group at D7 (V5), M1 (V6), M2 (V7) and M3 (V8), The remission rate defined as the proportion of patients with remission (i.e. MADRS score <10) in each group at D7 (V5), M1 (V6), M2 (V7) and M3 (V8), Side effects in all groups between study drug administration at D0 (V3), D1 (V4), D7 (V5), M1 (V6), M2 (V7) and M3 (V8) including vital signs worsening and biological adverse events (AE) (laboratory exams worsening), YMRS scores at Inclusion (V1), Baseline (V2), H7 (V3), D1 (V4), D7 (V5), M1 (V6), M2 (V7) and M3 (V8) in each group, Proportion of patients with an introduction of a new antidepressant after study treatment administration (D0) in each group, Correlation degree between maximal 5D-ASC and Mystical Experience Questionnaire (MEQ30) scores recorded during study drug administration (D0) and therapeutic efficacy assessed by MADRS score at M1 (V6), Stanford Expectations of Treatment Scale (SETS) score and the Credibility/Expectancy Questionnaire (CEQ) score at Baseline (V2) according to MADRS score at D7 (V5), M1 (V6), M2 (V7) and M3 (V8), Quality of Life in Depression Scale (QLDS) score at Inclusion (V1), Baseline (V2), D7 (V5), M1 (V6), M2 (V7) and M3 (V8), Cognitive task performance measured before (Baseline (V2)), during (D0 (V3)) and after study treatment administration (D7 (V5), M1 (V6) and M3 (V8)) by accuracy, reaction time and EEG signals, Brain activity measured by resting EEG before (Baseline (V2)), during (D0 (V3)) and after study treatment administration (D7 (V5), M1 (V6) and M3 (V8)), Immune and neuroplasticity biomarkers dosage before (Baseline (V2)) and after study treatment administration (D1 (V4), D7 (V5), M1 (V6) and M3 (V8)), Independent factors and clinical response obtained during the study, defined as a 50% reduction in MADRS score, Brain structure and activity measured by Magnetic Resonance Imaging (MRI) and EEG in the Group 4 during the open-label extension phase (if applicable). MRI + EEG will be recorded at rest and during the performance of cognitive tasks, before psilocybin administration (V2) and after administration (D7 ± 1 day (V5) and M1 ± 3 days (V6)), MADRS scores at Baseline (V2) and M1 (V6) in the Group 4 and 4C (receiving psilocybin 25 mg in the open-label extension phase) as within-subject measures of psilocybin efficacy, MADRS scores at Baseline (V2) and M1 (V6) in the Group 1 and 4C (receiving psilocybin 25 mg in the open-label extension phase) as within-subject measures of efficacy and in the Group 1 and 4C to assess the influence of blindness

Source: https://euclinicaltrials.eu/ctis-public/view/2024-512911-34-00